EU clinical trial 2024-514706-31-01: CHIPPI-1808: Phase III randomized clinical trial evaluating hyperthermic intraperitoneal chemotherapy (HIPEC) in ovarian cancer considering two different settings: Primary Debulking Surgery (PDS) and Interval Debulking Surgery (IDS)
Sponsor: Centre Oscar Lambret (Pharmaceutical company). Phase: Therapeutic confirmatory (Phase III). Countries: France (ongoing, recruitment ended), Belgium (ongoing, recruitment ended).
Therapeutic area(s): Diseases [C] - Neoplasms [C04]
Gender: Female. Age: 18-64 years, 65+ years. Enrolment: 352.
Status: Ongoing, recruitment ended. Start date (EU): 2019-05-02. Decision date: 2024-11-18. Results received: No. Last updated: 2025-10-02.
Decision dates by country: FR: 2024-11-19, BE: 2024-11-18

Condition(s): Epithelial ovarian cancer, Fallopian tube ovarian cancer, Peritoneal ovarian cancer
Product: SODIUM THIOSULFATE, CISPLATIN

Primary endpoint: Disease-Free Survival (DFS) will be computed as the time interval between randomization and progression, relapse or death from any cause. Progression and relapses will be assessed according to GCIG criteria1 and ideally confirmed by local tumor board. For patients alive without progression or relapse, data will be censored at the date of last follow-up visit.
Endpoint(s): Overall survival : OS will be computed as the time interval between randomization and death from any cause. For patients alive, data will be censored at the date of last follow-up., Adverse events will be evaluated according to NCI-CTCAE V5.0 over the whole treatment duration from randomization up to the end of treatment (surgery or chemotherapy) plus 30 days, excluding AE unequivocally related to the disease under study or its progression. Adverse events of grade 3 or more (grade 3+) will be counted as severe adverse events., The impact of HIPEC on the feasibility of adjuvant treatment will be assessed by describing the time interval between surgery and start of adjuvant chemotherapy. We will consider that start of chemotherapy is delayed if this time interval is larger than 6 weeks. In this case, the reasons will be described. - describing the total number of chemotherapy courses (neo-adjuvant+adjuvant). If the total number of chemotherapy course is below the planned number of 6, the reasons will be described., Quality-adjusted time without symptoms of disease or toxicity (Q-TWiST) computed from survival times (overall survival and progression-free survival) and adverse events data (date of occurrence of grade 3+ adverse event) as detailed in the statistical considerations., Quality of life will be evaluated using the European Organisation for Research and Treatment of Cancer (EORTC) Quality of Life Questionnaire–Score 30 (QLQ-C30), and Quality of Life Questionnaire–Ovarian Cancer Module (QLQ-OV28), Exploratory endpoint : Count of residual viable cells (evaluated by flow cytometry) in abdominal drainage fluids, Exploratory endpoint : Further research projects on the constituted biobank (tumor samples and blood samples) could be performed if additional and specific funding is obtained

Source: https://euclinicaltrials.eu/ctis-public/view/2024-514706-31-01